EU clinical trial 2022-503022-13-00: ISIS 678354-CS9: A Randomized, Double-blind, Placebo-Controlled, Phase 3 Study of Olezarsen (ISIS 678354) in Patients with Hypertriglyceridemia and Atherosclerotic Cardiovascular Disease (Established or at Increased Risk for), or with Severe Hypertriglyceridemia
Protocol code: ISIS 678354-CS9
Sponsor: Ionis Pharmaceuticals Inc. (Pharmaceutical company). Phase: Therapeutic confirmatory (Phase III). Countries: Denmark (ended), Spain (ended), France (ended), Poland (ended), Bulgaria (ended), Netherlands (ended), Hungary (ended), Norway (ended), Portugal (ended), Italy (ended), Czechia (ended), Finland (ended), Slovakia (ended).
Therapeutic area(s): Diseases [C] - Nutritional and Metabolic Diseases [C18]; Diseases [C] - Cardiovascular Diseases [C14]
Gender: Female, Male. Age: 18-64 years, 65+ years. Enrolment: 577.
Status: Ended. Start date (EU): 2023-06-08. End date (EU): 2025-05-30. End date: 2025-05-31. Decision date: 2023-05-16. Results received: Yes. Last updated: 2025-04-16.
Decision dates by country: FI: 2023-05-17, IT: 2023-05-29, ES: 2023-05-22, PL: 2023-05-22, HU: 2023-05-22, PT: 2023-05-16, NL: 2023-05-19, BG: 2023-05-22, FR: 2023-05-22, NO: 2023-05-23, SK: 2023-05-31, CZ: 2023-05-22, DK: 2023-05-16

Condition(s): Hypertriglyceridemia, Cardiovascular Diseases, Atherosclerosis
Product: Placebo lnjection, 1.5 ug/ml Riboflavin, 0.8ml, ISIS 678354

Primary endpoint: Percent change in fasting TG from Baseline at Week 25 compared to placebo.
Endpoint(s): Percent change in fasting TG from Baseline at Week 53 compared to placebo, Proportion of patients who achieve fasting TG < 150 mg/dL (1. 69 mmol/L) at Week 25 and proportion of patients who achieve fasting TG < 150 mg/dL at Week 53 compared to placebo, Percent change in fasting apoC-III, VLDL-C, remnant cholesterol, non-HDL-C, HDL-C, apoB, and LDL-C from Baseline at Week 25 and at Week 53 compared to placebo, Safety and tolerability assessments include: adverse events (AEs), vital signs and weight, physical examinations, clinical laboratory tests, electrocardiogram (ECG), and use of concomitant medications. Safety and tolerability results in patients receiving olezarsen will be compared with those receiving placebo.

Source: https://euclinicaltrials.eu/ctis-public/view/2022-503022-13-00